EU clinical trial 2022-502532-38-01: Dose Study of Tranexamic Acid in Total Hip Replacement to Reduce Postoperative Hemoglobin Loss. A Phase 2 Randomized Double-blind Monocentric Study. The PRADO study
Protocol code: 18CH052
Sponsor: Centre Hospitalier Universitaire De Saint Etienne (Hospital/Clinic/Other health care facility). Phase: Therapeutic exploratory (Phase II). Countries: France (ongoing, recruitment ended).
Therapeutic area(s): Diseases [C] - Musculoskeletal Diseases [C05]
Gender: Female, Male. Age: 18-64 years, 65+ years. Enrolment: 170.
Status: Ongoing, recruitment ended. Start date (EU): 2023-12-06. Decision date: 2023-04-20. Results received: No. Last updated: 2025-10-28.

Condition(s): Arthropathy of Hip
Product: CHLORURE DE SODIUM 0,9 % AGUETTANT, solution pour perfusion, APIXABAN, ACIDE TRANEXAMIQUE AGUETTANT 0,5 g/5 mL, solution injectable

Primary endpoint: Percentage of haemoglobin decrease in the perioperative period. It requires the sampling of haemoglobin before surgery and on the fourth postoperative day.
Endpoint(s): For tranexamic acid pharmacokinetics, the outcome measure is the sampling of tranexamic blood concentration., For tranexamic acid pharmacodynamics, the outcome is the sampling of D-Dimer levels., For allogenic red blood cell transfusion, the outcome measure will be the percentage of patients that will receive the transfusion of at least one allogenic red blood cell unit in the perioperative period., For severe anaemia (defined as a level of haemoglobin <10 gram by deciliter), the outcome measure will be the percentage of patients that will have at least one value of haemoglobin <10 gram by deciliter in the perioperative period., For the incidence of symptomatic thrombotic events and death, the outcome measure is a combined criteria of venous events (deep venous thrombosis or pulmonary embolism), arterial events (acute coronary syndrome, stroke or peripheral arterial thrombosis) and death., Measure, at D45 ± 1 week, the incidence of complications such as: venous/arterial thromboembolism, presence of hematoma requiring repeat surgery or associated with infection., To explore the consistency and extent of the dose-response effect of tranexamic acid during the first postoperative week, the primary endpoint will also be measured at the end of surgery, at 24 hours, and on day 8.

Source: https://euclinicaltrials.eu/ctis-public/view/2022-502532-38-01